EU clinical trial 2023-506239-14-00: I6T-MC-AMAZ: A master protocol for a Phase 3, multicenter, open-label, long-term extension study to evaluate the long-term efficacy and safety of mirikizumab in children and adolescents with moderate-to-severe ulcerative colitis or Crohn’s disease
Protocol code: I6T-MC-AMAZ
Sponsor: Eli Lilly & Co. (Pharmaceutical company). Phase: Therapeutic confirmatory (Phase III). Countries: Poland (ongoing, recruiting), Italy (ongoing, recruiting), Austria (authorised, recruitment pending), Belgium (ongoing, recruiting), France (authorised, recruitment pending), Germany (ongoing, recruiting), Spain (authorised, recruiting), Netherlands (authorised, recruitment pending), Portugal (ongoing, recruiting), Norway (authorised, recruitment pending).
Therapeutic area(s): Diseases [C] - Digestive System Diseases [C06]
Gender: Female, Male. Age: 0-17 years, 18-64 years. Enrolment: 65.
Start date (EU): 2022-12-13. Decision date: 2023-10-31. Results received: No. Last updated: 2026-06-30.
Decision dates by country: BE: 2024-08-27, AT: 2024-09-15, FR: 2024-08-28, PT: 2025-12-10, ES: 2024-08-27, NO: 2026-05-20, DE: 2024-09-05, NL: 2024-09-10, IT: 2023-10-31, PL: 2023-11-02

Condition(s): Ulcerative Colitis, Ulcerative Colitis Chronic, Inflammatory Bowel Diseases, Crohn’s Disease
Product: Mirikizumab, Mirikizumab, Mirikizumab

Primary endpoint: Percentage of Participants with UC in Modified Mayo Score (MMS) Clinical Remission. Clinical Remission based on the MMS [Time Frame: Week 52], Percentage of Participants with CD in Pediatric Crohn’s Disease Activity Index (PCDAI) Clinical Remission. Clinical Remission based on the PCDAI [Time Frame: Week 52]

Source: https://euclinicaltrials.eu/ctis-public/view/2023-506239-14-00